EU clinical trial 2023-504214-30-00: A Randomized, 2-cohort, Double-blind, Placebo-controlled, Phase III Study of Saruparib (AZD5305) in Combination with Physician’s Choice New Hormonal Agents in Patients with HRRm and non-HRRm Metastatic Castration-Sensitive Prostate Cancer (EvoPAR-Prostate01).
Protocol code: D9723C00001
Sponsor: AstraZeneca AB (Pharmaceutical company). Phase: Therapeutic confirmatory (Phase III). Countries: Belgium (ongoing, recruiting), Netherlands (ongoing, recruitment ended), Germany (ongoing, recruitment ended), Sweden (ended), Finland (ended), Poland (ongoing, recruitment ended), Italy (ongoing, recruiting), France (ongoing, recruitment ended), Spain (ongoing, recruitment ended), Hungary (ongoing, recruitment ended), Austria (ongoing, recruitment ended).
Therapeutic area(s): Diseases [C] - Neoplasms [C04]
Gender: Male. Age: 18-64 years, 65+ years. Enrolment: 540.
Start date (EU): 2024-06-27. Decision date: 2024-03-18. Results received: No. Last updated: 2026-08-06.
Decision dates by country: SE: 2024-03-22, FI: 2024-03-19, IT: 2024-06-12, ES: 2024-06-17, HU: 2024-06-13, PL: 2024-03-25, AT: 2024-06-17, NL: 2024-03-21, FR: 2024-03-21, BE: 2024-03-18, DE: 2024-06-12

Condition(s): Metastatic Castration-Sensitive Prostate Cancer (mCSPC)
Product: Xtandi - 40 mg film-coated tablets, Placebo to match (PTM) tablets, NUBEQA 300 mg film-coated tablets, Abiraterone Teva 500 mg film-coated tablets, ZYTIGA 250 mg tablets, Saruparib, BAY 1841788, ZYTIGA 500 mg film-coated tablets

Primary endpoint: Radiographic progression-free survival, defined as the time from randomisation to radiographic progression, as assessed by the investigator per RECIST 1.1 (soft tissue) and/or PCWG3 criteria (bone) or death due to any cause.
Endpoint(s): Overall Survival, defined as the time from the date of randomisation until death due to any cause., Time to Second Progression or Death (PFS2), defined as the time from randomisation to the earliest progression after initiation of first subsequent treatment following the initial investigator-assessed progression or death., Time to First Subsequent Therapy or Death (TFST), defined as the time from randomisation to the start date of the first subsequent anticancer therapy after discontinuation of randomised treatment, or death due to any cause., Symptomatic Skeletal Event-free Survival., Time to Castration-Resistance (TTCR), defined as the time from randomisation to the first castration-resistant event., Clinical Outcome Assessments, including TTPP, TTDUS, TTDF, TTDPF, and HRQoL.

Source: https://euclinicaltrials.eu/ctis-public/view/2023-504214-30-00